EU clinical trial 2026-526388-39-00: Calcium Electroporation for Urinary Bladder Tumors: A First-in-Human Feasibility, Safety, and Early Response Trial - The CALCIFER Trial
Sponsor: Region Sjaelland (Hospital/Clinic/Other health care facility). Phase: Human Pharmacology (Phase I)- Other. Countries: Denmark (authorised, recruitment pending).
Therapeutic area(s): Diseases [C] - Female Urogenital Diseases and Pregnancy Complications [C13]; Analytical,Diagnostic,Therapeutic Techniques and Equipment [E]-Surgical Procedures, Operative [E04]; Diseases [C] - Male Urogenital Diseases [C12]; Diseases [C] - Neoplasms [C04]
Gender: Female, Male. Age: 18-64 years, 65+ years. Enrolment: 20.
Status: Authorised, recruitment pending. Decision date: 2026-07-03. Results received: No. Last updated: 2026-07-03.

Condition(s): Bladder cancer, Bladder tumors, Urothelial cancer, Urothelial tumors

Source: https://euclinicaltrials.eu/ctis-public/view/2026-526388-39-00